EU clinical trial 2025-524373-17-00: MERCURE study: MEthotrexate in ReCurrent dVIN
Protocol code: MERCURE524372
Sponsor: Amsterdam UMC Stichting (Patient organisation/association). Phase: Therapeutic use (Phase IV). Countries: Netherlands (authorised, recruitment pending).
Therapeutic area(s): Diseases [C] - Skin and Connective Tissue Diseases [C17]; Diseases [C] - Female Urogenital Diseases and Pregnancy Complications [C13]
Gender: Female. Age: 18-64 years, 65+ years. Enrolment: 30.
Status: Authorised, recruitment pending. Decision date: 2026-04-28. Results received: No. Last updated: 2026-04-28.

Condition(s): dVIN caused by Lichen Sclerosus
Product: Methotrexaat Sandoz 2,5 mg, tabletten

Primary endpoint: To assess effectiveness of MTX in prevention of recurrence in dVIN, recurrence rates with or without MTX will be compared within this prospective self-controlled pilot study, as each patient functions as its own control., Time-to recurrence of dVIN in women with lichen sclerosus and recurrent dVIN lesions with- and without the use of MTX will also be assessed by determination of clinical responses at 1-3-6-9-12-15-18 months and will be identified as stable disease (SD) or progressive disease (PD).
Endpoint(s): Safety and tolerability of side effects, reduction of vulvar complaints, reduction of topical corticosteroid application and patient satisfaction with the use of MTX will be evaluated by patient reported use and documentation of side effects using a questionnaire. Severity of side effects will be evaluated according to the CTCEA version 5.0 2017., Pre-treatment and, when performed, current- or post-treatment biopsies will be identified and central blinded pathology revision will be performed. To explore microenvironment in recurrent dVIN with and without the use of MTX immunohistochemistry staining, including p53 will be performed.

Source: https://euclinicaltrials.eu/ctis-public/view/2025-524373-17-00